EU clinical trial 2023-504847-15-00: Intranasal Sufentanil for Analgesia of Severe Sickle Cell Vaso-occlusive Pain Crisis in the Pediatric Emergency Department: a Double Blind Randomized versus placebo Controlled Trial (INVOPE)
Protocol code: APHP211035
Sponsor: Assistance Publique Hopitaux De Paris (Hospital/Clinic/Other health care facility). Phase: Therapeutic confirmatory (Phase III). Countries: France (ongoing, recruiting).
Therapeutic area(s): Diseases [C] - Hemic and Lymphatic Diseases [C15]; Diseases [C] - Congenital, Hereditary, and Neonatal Diseases and Abnormalities [C16]
Gender: Female, Male. Age: 0-17 years. Enrolment: 915.
Status: Ongoing, recruiting. Start date (EU): 2025-07-21. Decision date: 2023-11-24. Results received: No. Last updated: 2025-12-22.

Condition(s): vaso-occlusive crisis due to sickle cell disease
Product: Sufentanil Mylan 50 microgrammes/ml solution injectable, MORPHINE HYDROCHLORIDE, CHLORURE DE SODIUM 0,9 % LAVOISIER, solution pour perfusion

Primary endpoint: Proportion of children relieved at 30 minutes after the IN spray. The pain will be evaluated with : An hetero-evaluation by the EVENDOL Scale for children aged less than 8 years. An auto-evaluation by the Numeric Pain Rating Scale (NRS-11) for children aged 8 years to less than 18 years. Pain relief is defined as EVENDOL score ≤ 5/15 or NRS-11 score ≤ 3/10.
Endpoint(s): a) Proportion of children relieved (EVENDOL ≤ 5/15 or NRS-11 ≤ 3/10) at 10, 20, 40, 50 and 60 minutes after the IN spray;, b) Proportion of children with a moderate pain (EVENDOL ≤ 9/15 or NRS-11 ≤ 6/10) at 10, 20, 30, 40, 50 and 60 minutes after the IN spray;, c) Time from triage to relief (EVENDOL ≤ 5/15 or NRS-11 ≤ 3/10) Time from triage to venous access Time from triage to IV morphine initiation Proportion of children with a first dose of opioids within 30 min of arrival Time from triage to parenteral opioid initiation (IV morphine or IN Sufentanil) Time from triage to admission/discharge decision, d) Morphine consumption (mg) 60, 120 and 240 minutes after the IN injection;, e) Rates of hypotension, hypoxia, bradycardia, respiratory distress, headache, nausea, vomiting, sleepiness and itchiness until 4 hours after the IN injection;, f) All adverse events;, g) Rate of admission after the ED visit Length of hospital stay: at hospital discharge;, h) Rate of Acute chest syndrome: at hospital discharge Rate of admission in ICU, invasive ventilation, non-invasive ventilation, oxygene therapy: at hospital discharge Rate of Transfusion: at hospital discharge Rate of death: at hospital discharge, i) Satisfaction with the quality of analgesia and management during the emergency room stay = For children ≥ 8 years - Global satisfaction with treatment (NRS-11, by children and parent) -Total Quality Pain Management and Desire to receive the same intranasal treatment during a future severe VOC by children and parent o For children < 8 years -Global satisfaction with treatment (NRS-11, by parent) -Total Quality Pain Management and Desire to receive the same intranasal treatmen

Source: https://euclinicaltrials.eu/ctis-public/view/2023-504847-15-00